EU clinical trial 2024-517866-40-00: C4531029:A Phase 2, Randomized, Double-Blind, Placebo-Controlled, Parallel-group, Dose-Ranging Study to Investigate the Efficacy and Safety of PF-07275315 in Adult Participants with Inadequately Controlled Moderate-to-Severe Asthma
Protocol code: C4531029
Sponsor: Pfizer Inc. (Pharmaceutical company). Phase: Therapeutic exploratory (Phase II). Countries: Belgium (ongoing, recruiting), Hungary (ongoing, recruiting), Spain (ongoing, recruiting), Bulgaria (ongoing, recruiting), Italy (ongoing, recruiting), Poland (ongoing, recruiting), Czechia (ongoing, recruiting).
Therapeutic area(s): Diseases [C] - Respiratory Tract Diseases [C08]
Gender: Female, Male. Age: 18-64 years, 65+ years. Enrolment: 90.
Status: Ongoing, recruiting. Start date (EU): 2025-09-29. Decision date: 2025-08-26. Results received: No. Last updated: 2026-06-01.
Decision dates by country: HU: 2025-08-28, ES: 2025-08-29, CZ: 2025-08-26, IT: 2025-08-26, BE: 2025-08-26, PL: 2025-09-01, BG: 2025-09-01

Condition(s): Moderate-to-severe Asthma

Primary endpoint: Change from baseline (CFB) in pre-bronchodilator forced expiratory volume (in mL) in one second (FEV1) at Week 12., Incidence of treatment-emergent adverse events (TEAEs, all causality and treatment-related)., Incidence of treatment-emergent serious adverse events (SAEs)., Discontinuations due to TEAEs or SAEs., Clinically significant, treatment-related abnormal laboratory values, vital signs or electrocardiograms.
Endpoint(s): Key Secondary: • CFB in pre-bronchodilator % predicted FEV1, at Week 12., Other Secondary: CFB in pre-bronchodilator lung function parameters (ie, FEV1 *, % predicted FEV1*, Forced vital capacity [FVC], % predicted FVC, FEV1/FVC ratio) at all other time points., CFB in post-bronchodilator lung function parameters (ie, FEV1 , % predicted FEV1 (all time points except Week 12), FVC , % predicted FVC, FEV1/FVC ratio) at all other time points., Percentage CFB in pre-BD FEV1 at all time points., CFB in pre-bronchodilator FEV1 at Week 12., CFB in pre-bronchodilator FEV1 at Week 12., CFB in asthma control questionnaire (5-question version [ACQ-5]) total score at Week 12., CFB in asthma quality of life questionnaire with standardized activities (AQLQ) self-administered global score at Week 12., CFB in pre- bronchodilator FEV1 at Week 12.

Source: https://euclinicaltrials.eu/ctis-public/view/2024-517866-40-00